EU clinical trial 2024-520287-34-01: A phase II randomized, double-blind, placebo-controlled trial to evaluate the efficacy, safety, and tolerability of an oral solution of 9-Δ tetrahydrocannabinol/cannabidiol (THC/CBD) in multiple sclerosis patients with chronic neuropathic pain
Protocol code: BLCL-THC/CBD-01
Sponsor: Ferraz Lynce Especialidades Farmaceuticas S.A. (Pharmaceutical company). Phase: Therapeutic exploratory (Phase II). Countries: Portugal (ongoing, recruiting).
Therapeutic area(s): Diseases [C] - Nervous System Diseases [C10]
Gender: Female, Male. Age: 18-64 years, 65+ years. Enrolment: 68.
Status: Ongoing, recruiting. Start date (EU): 2025-09-12. Decision date: 2025-06-24. Results received: No. Last updated: 2026-02-23.

Condition(s): Chronic neuropathic pain due to multiple sclerosis (MS)
Product: Satalliv, Delta-9-tetrahydrocannabinol/cannabidiol (THC:CBD) 25 mg + 25 mg/mL, oral solution, Matching placebo oral solution

Primary endpoint: Efficacy: Change in pain intensity as measured by the Numeric Rating Scale (NRS 0-10) between baseline (Day 1) and 4 weeks of optimized treatment (corresponding to Week 6 visit); the mean of the last four available ratings in the 7 days prior to a study visit will be considered.
Endpoint(s): Efficacy: Proportion of patients who achieved at least a 30% reduction in their pain NRS 0-10 score after 4 weeks of optimized treatment, Efficacy: Proportion of patients who achieved at least a 50% reduction in their pain NRS 0-10 score after 4 weeks of optimized treatment, Efficacy: Change in pain intensity as measured by the NRS 0-10 between baseline (Day 1) and 12 weeks of optimized treatment, Efficacy: Proportion of patients who achieved at least a 30% reduction in their pain NRS 0-10 score after 12 weeks of optimized treatment, Efficacy: Proportion of patients who achieved at least a 50% reduction in their pain NRS 0-10 score after 12 weeks of optimized treatment, Efficacy: Proportion of patients who achieved at least a 30% reduction in spasticity NRS 0-10 score after 4 weeks of optimized treatment., Efficacy: Proportion of patients who achieved at least a 30% reduction in spasticity NRS 0-10 score after 12 weeks of optimized treatment., Efficacy: Change in spasticity symptom measured by the NRS 0-10 between baseline (Day 1) and 4 weeks of optimized treatment and baseline and 12 weeks of optimized treatment (0: No spasticity - The patient experiences no increase in muscle tone or involuntary muscle spasms; 10: Worst possible spasticity - The patient experiences extreme muscle stiffness, severe spasms, and significant difficulty with movement), Efficacy: Change in Pittsburgh Sleep Quality Index (PSQI) component scores and global score between baseline (Day 1) and 4 weeks of optimized treatment and baseline and 12 weeks of optimized treatment, Efficacy: Change in EuroQol 5-Dimensions, 5-Levels (EQ-5D-5L) index score between baseline (Day 1) and 12 weeks of optimized treatment, Efficacy: Change in EQ-5D-5L visual analogue scale (VAS) score between baseline (Day 1) and 12 weeks of optimized treatment, Efficacy: Proportion of patients reporting improvement in their condition with Patient Global Impression of Change (PGIC) scale after 4 and 12 weeks of optimized treatment, Efficacy: Change in the Expanded Disability Status Scale (EDSS) score between baseline (Day 1) and 4 weeks of optimized treatment and from baseline and 12 weeks of optimized treatment, Efficacy: Change in the Nine-Hole Peg test (NHPT) completion time from baseline (Day 1) and 4 weeks of optimized treatment and between baseline and 12 weeks of optimized treatment., Efficacy: Reduction of at least a 30% Neuropathic Pain Symptom Inventory (NPSI) score after 4 and 12 weeks of optimized treatment., Safety: Incidence of treatment-emergent adverse events (TEAEs), serious adverse events (SAEs), and adverse events (AE) leading to study discontinuation. Clinically relevant abnormalities in vital signs, 12-lead electrocardiogram (ECG) and laboratory parameters will be reported as AEs.

Source: https://euclinicaltrials.eu/ctis-public/view/2024-520287-34-01